EU clinical trial 2024-516300-41-00: A randomized phase III non-inferiority trial assessing lenalidomide, bortezomib and dexamethasone induction therapy with either intravenous or subcutaneous isatuximab in transplant-eligible patients with newly diagnosed multiple myeloma (GMMG HD8/ DSMM XIX)
Protocol code: GMMG-HD8/DSMM XIX
Sponsor: Universitaetsklinikum Heidelberg AöR (Hospital/Clinic/Other health care facility). Phase: Therapeutic confirmatory (Phase III). Countries: Austria (ended), Germany (ended).
Therapeutic area(s): Diseases [C] - Hemic and Lymphatic Diseases [C15]; Diseases [C] - Neoplasms [C04]
Gender: Female, Male. Age: 18-64 years, 65+ years. Enrolment: 514.
Status: Ended. Start date (EU): 2023-03-07. End date (EU): 2026-01-30. Decision date: 2024-11-04. Results received: No. Last updated: 2026-03-04.
Decision dates by country: AT: 2024-11-08, DE: 2024-11-04

Condition(s): Multiple Myeloma
Product: VELCADE 3.5 mg powder for solution for injection, Lenalidomid HEXAL 10 mg Hartkapseln, Lenalidomid HEXAL 15 mg Hartkapseln, DEXAMETHASONE, Lenalidomid HEXAL 5 mg Hartkapseln, Isatuximab, Isatuximab, Lenalidomid HEXAL 25 mg Hartkapseln

Primary endpoint: Rates of VGPR or better (according to standard IMWG response criteria), defined as proportion of patients with at least VGPR after induction therapy
Endpoint(s): PRO outcomes score assessed by CTSQ (subdomain “satisfaction with therapy”) for SC vs. IV isatuximab application on induction therapy, Rates of NGS-MRD negativity (sensitivity 10^-5, from BMA) after induction therapy

Source: https://euclinicaltrials.eu/ctis-public/view/2024-516300-41-00